EU clinical trial 2023-508072-11-00: A Phase III trial of acetylsalicylic acid and atorvastatin in patients with castrate-resistant prostate cancer (PEACE 4)
Protocol code: 2017/2601 PEACE 4
Sponsor: Institut Gustave Roussy (Hospital/Clinic/Other health care facility). Phase: Therapeutic confirmatory (Phase III). Countries: France (ongoing, recruiting), Czechia (authorised, recruitment pending).
Therapeutic area(s): Diseases [C] - Male Urogenital Diseases [C12]; Diseases [C] - Neoplasms [C04]
Gender: Male. Age: 18-64 years, 65+ years. Enrolment: 1230.
Start date (EU): 2019-06-26. Decision date: 2023-11-13. Results received: No. Last updated: 2026-06-03.
Decision dates by country: FR: 2023-11-13, CZ: 2026-02-05

Condition(s): Castration-resistant prostate cancer
Product: RESITUNE 100 mg, comprimé gastro-résistant, TAHOR 80 mg, comprimé pelliculé

Primary endpoint: Overall survival (OS). OS will be calculated from the date of randomization to the date of death (or the last follow-up date in case of censored data).
Endpoint(s): Prostate cancer specific survival (events including only deaths due to prostate cancer), Progression-Free Survival (including PSA progression by PCWG3 criteria (recommended) or if not by investigator’s assessment), Radiographic Progression-Free Survival (progression defined by PCWG3 criteria), Time to next anticancer treatment, Safety (NCI-CTC V5.0 criteria). G1 to G5 acetylsalicylic acid and statin-related known AEs and all the other events only G3-5., G1 to G5 AEs considered related to acetylsalicylic acid and/or statin and about all others AEs only G3-5 have to be collected., Cardio-vascular morbidity: cardiovascular hospitalization (e.g. stroke, myocardial infarction) and cardio-vascular mortality or any G3/4 cardiovascular AE, Changes from baseline of BMI (BMI=weight (kg)/height (m)2), body weight and waist measure under treatment, Translational research: Metabolic parameters (including baseline lipid profile and change in levels of lipids under treatment), Translational research: Low levels of Vitamin D at baseline, Translational research: LNR (Lymphocyte to Neutrophil Ratio) and CRP, Translational research: Lipid signature

Source: https://euclinicaltrials.eu/ctis-public/view/2023-508072-11-00